EU clinical trial 2025-522522-13-01: A Phase 2a, Randomized, Double-Blind, Placebo-Controlled Dose Comparison and Exploratory Efficacy Study of Orally Administered SAT-3247 in Ambulatory DMD Patients
Protocol code: SAT-3247-CL-201
Sponsor: Satellos Bioscience Inc. (Pharmaceutical company). Phase: Therapeutic exploratory (Phase II). Countries: Spain (ongoing, recruiting), Belgium (ongoing, recruiting), Poland (authorised, recruiting).
Therapeutic area(s): Diseases [C] - Musculoskeletal Diseases [C05]; Diseases [C] - Nervous System Diseases [C10]
Gender: Male. Age: 0-17 years. Enrolment: 32.
Start date (EU): 2026-04-08. Decision date: 2026-01-22. Results received: No. Last updated: 2026-07-07.
Decision dates by country: ES: 2026-02-17, BE: 2026-01-30, PL: 2026-01-30

Condition(s): Duchenne muscular dystrophy
Product: SAT-3247 10mg tablet, Placebos for SAT-3247 tablets are required for the clinical trial. To match the appearance of SAT-3247 active tablets, placebo tablets are formulated by replacing SAT-3247 oxalate DS with lactose monohydrate and microcrystalline cellulose., SAT-3247 50mg tablet

Primary endpoint: The primary efficacy endpoint is defined as the change from baseline in muscle force measurements as determined by dynamometry at Week 12., Safety endpoints include incidence, temporal profile, and severity of treatment emergent adverse events (TEAEs), Occurrence of clinically significant changes in physical examination, clinical laboratory measures, vital signs, ECG, and C-SSRS, Part 2 of the study safety: Incidence, temporal profile, and severity of treatment emergent adverse events (TEAEs), Part 2 of the study safety: Occurrence of clinically significant changes in physical examination, clinical laboratory measures, vital signs, ECG, and C-SSRS, Part 2 of the study Efficacy: Change from Part 1 study baseline in muscle function up to Month 12.
Endpoint(s): Changes from baseline in intramuscular fat fraction in muscle quantitative magnetic resonance (qMR) in vastus lateralis at Week 12, Changes from baseline in proton muscle transverse relaxation time (T2) in vastus lateralis at Week 12., Changes from baseline in Regeneration Index in open muscle biopsy of the biceps brachii at Week 12, Changes from baseline in function as determined by NSAA assessment at Week 12, Changes from baseline in SV95C at Week 12, Exploratory end point: change from baseline in inflammatory cytokine profile at Week 12, Exploratory end point: change from baseline in creatine kinase at Week 12, Exploratory end point: change from baseline in maximum percent predicted forced vial capacity as measured by spirometry at Week 12, Exploratory end point: change in biceps brachii muscle fiber size and fiber size distribution as determined from histopathology at 12 weeks, Exploratory end point: change in the proportion of embryonic myosin positive fibers as determined from histopathology at 12 weeks., Exploratory end point: change in the number of satellite cells as determined from histopathology at 12 weeks, Exploratory end point: change in endomysial fibrosis and adipose tissue infiltration as determined from histopathology at 12 weeks., Exploratory end point: change in NSAA score over 12 weeks as compared to natural history, Exploratory endpoint: Change from baseline in proteomic profile at Week 12., part 2 of the study: Changes from Part 1 study baseline in intramuscular fat fraction in muscle quantitative magnetic resonance (qMR) in vastus lateralis up to Month 12., Part 2 of the study: Change from Part 1 study baseline in proton muscle transverse relaxation time (T2) in vastus lateralis up to Month 12., Part 2 of the study: Changes from Part 1 study baseline in muscle force measurements as determined by dynamometry up to Month 12., Part 2 of the study: Changes from Part 1 study baseline in North Star Ambulatory Assessment up to Month12., Part 2 of the study: Change from Part 1 study baseline in Four Stair Climb (4SC) up to Month 12, Part 2 of the study: Changes from Part 1 study baseline in Stride Velocity 95th Centile (SV95C) up to Month 12., Part 2 of the study exploratory: Changes from Part 1 study baseline in maximum percent predicted forced vital capacity as measured by spirometry up to Month 12., Part 2 of the study exploratory: Change from Part 1 study baseline in inflammatory cytokine profile up to Month 12., Part 2 of the study exploratory: Change from Part 1 study baseline in creatine kinase up to Month 12, Part 2 of the study exploratory: Changes from baseline in proteomic profile up to Month 12., Part 2 of the study exploratory: Changes from baseline in DMDCR-HI up to Month 12., Part 2 of the study exploratory: Treatment benefit highlights as gathered through qualitative exit interviews up to Month 12 in willing participants/caregivers., PK: Characterize the plasma PK by calculating the following SAT-3247 parameters: o maximum concentration (Cmax), o time to maximum concentration (Tmax), o area under the curve (AUC) from time 0 to the last measurable concentration (AUC0 last), o AUC from time 0 to infinity (AUC∞), o Apparent terminal half-life (t½).

Source: https://euclinicaltrials.eu/ctis-public/view/2025-522522-13-01